EU clinical trial 2024-512040-28-01: The PEARL trial: Prevention of hepatic Encephalopathy by administration of Rifaximin and Lactulose in patients with liver cirrhosis undergoing placement of a transjugular intrahepatic portosystemic shunt: a multi-centre randomized, double blind, placebo controlled trial.
Sponsor: Amsterdam UMC Stichting (Hospital/Clinic/Other health care facility). Phase: Therapeutic use (Phase IV). Countries: Netherlands (ongoing, recruiting), Belgium (ongoing, recruiting).
Therapeutic area(s): Not possible to specify
Gender: Female, Male. Age: 18-64 years. Enrolment: 91.
Status: Ongoing, recruiting. Start date (EU): 2026-03-01. Decision date: 2024-11-04. Results received: No. Last updated: 2024-11-06.
Decision dates by country: BE: 2024-11-06, NL: 2024-11-04

Condition(s): Confirmed diagnosis of Alcoholic liver cirrhosis
Product: RIFAXIMIN ALFASIGMA 550 mg film-coated tablets, Lactulose EG 670 mg/ml, sirop, Placebo for rifaximin

Primary endpoint: Primary endpoint is the development of OHE within three months after TIPS placement determined by the West Haven criteria.
Endpoint(s): Secondary endpoints include 90-day mortality; development of a second episode of OHE within the first three months; development of OHE in the period between three and twelve months after TIPS placement; development of MHE between TIPS placement and twelve months post-placement; time to development of OHE or MHE episodes; the increase in PHES, S-ANT1 score and LFI compared to baseline.

Source: https://euclinicaltrials.eu/ctis-public/view/2024-512040-28-01